EU clinical trial 2023-507130-24-00: A Phase IIIb, Global, Multicenter, Randomized, Visual Assessor−Masked Study of the Efficacy, Safety, and Pharmacokinetics of a 36-Week Refill Regimen for the Port Delivery System with Ranibizumab in Patients with Neovascular Age-Related Macular Degeneration (Velodrome)
Protocol code: WR42221
Sponsor: F. Hoffmann-La Roche AG (Pharmaceutical company). Phase: Therapeutic confirmatory (Phase III). Countries: Austria (ongoing, recruitment ended), Italy (ongoing, recruitment ended), Belgium (ended), Spain (ongoing, recruitment ended), France (ongoing, recruitment ended), Germany (ongoing, recruitment ended).
Therapeutic area(s): Diseases [C] - Eye Diseases [C11]
Gender: Female, Male. Age: 65+ years. Enrolment: 183.
Start date (EU): 2021-10-22. Decision date: 2024-07-15. Results received: No. Last updated: 2026-06-08.
Decision dates by country: BE: 2024-07-16, FR: 2024-07-25, DE: 2024-07-16, ES: 2024-07-15, AT: 2024-07-22, IT: 2024-07-17

Condition(s): Neovascular age-related macular degeneration (nAMD)
Product: RO4893594, RO4893594, Lucentis 10 mg/ml solution for injection in pre-filled syringe

Primary endpoint: Change from baseline in BCVA score averaged over Weeks 68 and 72, as assessed using the ETDRS chart starting at a distance of 4 meters
Endpoint(s): Change from baseline in BCVA score over time (up to and including Week 72), Proportion of patients with BCVA score of 69 letters or better averaged over Weeks 68 and 72, Proportion of patients with BCVA score of 69 letters or better over time, Proportion of patients with BCVA score of 38 letters or worse averaged over Weeks 68 and 72, Proportion of patients with BCVA score of 38 letters or worse over time, Proportion of patients who report preferring ranibizumab 100 mg/mL delivered via the PDS compared with intravitreal treatment, as measured by the PDS PPPQ at Weeks 24, 40 and 72, Proportion of patients with bilateral disease who report preferring ranibizumab 100 mg/mL delivered via the PDS compared with intravitreal treatment, as measured by the PPPQ at Weeks 24, 40 and 72, Mean overall treatment satisfaction at Week 40, as measured by the Macular Disease Treatment Satisfaction Questionnaire (MacTSQ) total score in the Q36W arm compared with the Q24W arm, Proportion of patients who lose <10, <5, or gain >= 0 letters in BCVA score from baseline averaged over Weeks 68 and 72, Proportion of patients who lose <10, <5, or gain >= 0 letters in BCVA score from baseline over time, Change from baseline in CPT up to and including Week 72, Change from baseline in CST over time, up to and including Week 72, Proportion of patients who do not undergo supplemental treatment with intravitreal ranibizumab 0.5 mg before each refill-exchange procedure, Incidence and severity of ocular and systemic adverse events in Q36W compared with Q24W, Incidence, severity, and duration of adverse events of special interest, including ocular adverse events of special interest in Q36W compared with Q24W, Incidence, severity, and duration of ocular adverse events of special interest during the postoperative period and follow-up period in all enrolled patients, Incidence and severity of adverse device effects in the Q36W and Q24W arms, Incidence, causality, severity, and duration of anticipated serious adverse device effects in the Q36W and Q24W arms, Observed serum concentration of ranibizumab at specified timepoints, Incidence of treatment-emergent ADAs to ranibizumab during the study

Source: https://euclinicaltrials.eu/ctis-public/view/2023-507130-24-00